EU clinical trial 2024-512007-39-00: A Phase 2a, open-label, two-part study to evaluate the mechanism of action of itepekimab (anti-IL-33 mAb) on airway inflammation in patients with chronic obstructive pulmonary disease (COPD)
Protocol code: PDY16967
Sponsor: Sanofi-Aventis Recherche & Developpement (Pharmaceutical company). Phase: Therapeutic exploratory (Phase II). Countries: Belgium (ended), Germany (ended), Netherlands (ended), Denmark (ended).
Therapeutic area(s): Diseases [C] - Respiratory Tract Diseases [C08]
Gender: Female, Male. Age: 18-64 years, 65+ years. Enrolment: 65.
Status: Ended. Start date (EU): 2022-06-20. End date (EU): 2025-07-22. End date: 2025-07-25. Decision date: 2024-05-15. Results received: Yes. Last updated: 2025-02-05.
Decision dates by country: BE: 2024-05-29, DK: 2024-05-16, DE: 2024-05-22, NL: 2024-05-15

Condition(s): Chronic Obstructive Pulmonary Disease
Product: Itepekimab

Primary endpoint: Change from baseline in itepekimab pharmacodynamic normalized enrichment score (NES) derived from former smokers in endobronchial biopsies in current smokers with COPD, Change from baseline in itepekimab pharmacodynamics NES derived from former smokers in bronchial brushings in current smokers with COPD, Change from baseline in itepekimab pharmacodynamics NES derived from former smokers in nasal brushings in current smokers with COPD
Endpoint(s): Change from baseline in IL-33 treated eosinophil-associated NES in endobronchial biopsies, Change from baseline in IL-33 treated mast cell-associated NES in endobronchial biopsies, Change from baseline in blood eosinophil count, Incidence of treatment-emergent adverse events (TEAEs), adverse event of special interests (AESIs), serious adverse events (SAEs), and adverse events (AEs) leading to permanent treatment discontinuation, Incidence of potentially clinically significant abnormalities in clinical laboratory tests, vital signs and electrocardiogram (ECG) abnormalities in the treatment-emergent period, Incidence of treatment-emergent anti-itepekimab antibody responses throughout the study, Functional itepekimab concentrations in serum

Source: https://euclinicaltrials.eu/ctis-public/view/2024-512007-39-00